EU clinical trial 2025-522120-28-00: Total Neoadjuvant Treatment with or without Tislelizumab for Locally Advanced Rectal Cancer: An Open-label Randomized Controlled Phase II Study (The TOTAL Trial)
Protocol code: TOTAL
Sponsor: Universitaetsmedizin der Johannes Gutenberg-Universitaet Mainz KöR, Rabin Medical Center (Hospital/Clinic/Other health care facility). Phase: Therapeutic exploratory (Phase II). Countries: Germany (ongoing, recruiting).
Therapeutic area(s): Diseases [C] - Neoplasms [C04]
Gender: Female, Male. Age: 18-64 years, 65+ years. Enrolment: 67.
Status: Ongoing, recruiting. Start date (EU): 2026-03-03. Decision date: 2026-02-10. Results received: No. Last updated: 2026-06-05.

Condition(s): Locally Advanced Rectal Cancer (LARC) stage II (T3-4N0M0) or stage III (TxN1-2M0)
Product: Tislelizumab

Primary endpoint: The primary endpoint is the 3-year TME-free survival rates (intention to treat, ITT)
Endpoint(s): - 3-year TME-free survival (CPS≥1%), - cCR, - DFS, - PFS, - OS rates, - safety and toxicity profile, - patient-reported functional outcomes and QoL (quality of life) with EORTC QLQ-C30 and CR-29

Source: https://euclinicaltrials.eu/ctis-public/view/2025-522120-28-00